EU clinical trial 2024-515662-14-00: A Single Dose, Fasting state, Crossover Replicate Bioequivalence Study of Naproxen 500 mg/Esomeprazole 20 mg, modified-release tablets (Antibiotice S.A.) vs. Vimovo® 500 mg/20 mg film-coated tablets (Grunenthal Gmbh)
Protocol code: NAESAIS 02/2024
Sponsor: Antibiotice S.A. (Pharmaceutical company). Phase: Human Pharmacology (Phase I)- Bioequivalence Study. Countries: Romania (ended).
Therapeutic area(s): Phenomena and Processes [G] - Musculoskeletal and Neural Physiological Phenomena [G11]; Diseases [C] - Musculoskeletal Diseases [C05]
Gender: Female, Male. Age: 18-64 years. Enrolment: 32.
Status: Ended. Start date (EU): 2024-10-31. End date (EU): 2024-12-18. Decision date: 2024-10-31. Results received: No. Last updated: 2024-10-31.

Condition(s): healthy subjects

Source: https://euclinicaltrials.eu/ctis-public/view/2024-515662-14-00